EU clinical trial 2024-514055-15-00: The PREDMETH trial: Effectiveness of methotrexate versus prednisone as first-line therapy for pulmonary sarcoidosis - A randomized controlled trial
Protocol code: NL71782.078.19
Sponsor: Erasmus Universitair Medisch Centrum Rotterdam (Erasmus MC) (Hospital/Clinic/Other health care facility). Phase: Therapeutic use (Phase IV). Countries: Netherlands (ongoing, recruiting).
Therapeutic area(s): Diseases [C] - Respiratory Tract Diseases [C08]
Gender: Female, Male. Age: 18-64 years, 65+ years. Enrolment: 132.
Status: Ongoing, recruiting. Start date (EU): 2024-11-19. Decision date: 2024-11-19. Results received: No. Last updated: 2024-11-19.

Condition(s): Pulmonary sarcoidosis
Product: METHOTREXATE, METHOTREXATE, PREDNISONE, METHOTREXATE

Primary endpoint: Change in hospital-measured Forced Vital Capacity
Endpoint(s): Biomarkers

Source: https://euclinicaltrials.eu/ctis-public/view/2024-514055-15-00